EU clinical trial 2024-515071-35-00: A Multicentre Surveillance Study to Evaluate the Long-term Safety in Participants who Have Been Previously Treated with 177Lu-IPN01072 in an Ipsen-sponsored Clinical Study
Protocol code: D-FR-01072-004
Sponsor: Ariceum Therapeutics GmbH (Pharmaceutical company). Phase: Therapeutic use (Phase IV). Countries: France (ended).
Therapeutic area(s): Diseases [C] - Neoplasms [C04]
Gender: Female, Male. Age: 18-64 years, 65+ years. Enrolment: 3.
Status: Ended. Start date (EU): 2022-01-06. End date (EU): 2025-04-29. Decision date: 2024-10-07. Results received: Yes. Last updated: 2024-10-07.

Condition(s): Somatostatin Receptor Positive Neuroendocrine Tumours (NETs)

Primary endpoint: Presence of participants with second primary haematological and non-haematological malignancies
Endpoint(s): Incidence of treatment-related adverse events of any grade according to the National Cancer Institute–Common Terminology Criteria for Adverse Events Version 5.0, including any treatment-related serious adverse events, as assessed by the investigators, Changes over time in laboratory tests (haematology and biochemistry), Overall survival defined as the time from the first dose of 177Lu-IPN01072 until death from any cause

Source: https://euclinicaltrials.eu/ctis-public/view/2024-515071-35-00